EU clinical trial 2025-522812-18-00: CARESS Study: Cabergoline for the Reduction of Endometriosis Symptoms and Lesion Size
Sponsor: Hospital Clinico San Carlos (Hospital/Clinic/Other health care facility). Phase: Phase III and phase IV (Integrated). Countries: Spain (authorised, recruitment pending).
Therapeutic area(s): Diseases [C] - Female Urogenital Diseases and Pregnancy Complications [C13]
Gender: Male. Age: 18-64 years. Enrolment: 120.
Status: Authorised, recruitment pending. Decision date: 2025-09-17. Results received: No. Last updated: 2025-09-17.

Condition(s): Endometriosis
Product: Sibilla diario 2 mg / 0,03 mg comprimidos recubiertos con película EFG, Dostinex 0.5 mg Tablets

Primary endpoint: Reduction in the size of endometriotic lesions assessed by transvaginal ultrasound/magnetic resonance imaging (MRI)/laparoscopy., Relief of pelvic pain measured by visual analogue scale (VAS) before and after treatment.
Endpoint(s): Demographic and clinical characteristics: Age, BMI, ethnicity, comorbidities (diabetes, hypertension, immunosuppression, smoking), Eznian classification (a system designed to describe deep infiltrating endometriosis (DIE) in a detailed and topographical manner, complementing the limitations of other classifications such as ASRM., Changes in serum prolactin and VEGF levels as pre- and post-treatment angiogenic markers., Impact on other symptoms associated with endometriosis, such as irregular bleeding and infertility, assessed clinically and through hormonal analysis (FSH, LH, estradiol, AMH)., Safety profile: frequency and type of adverse effects related to cabergoline (nausea, vomiting, dizziness)., Quality of life measured using specific questionnaires such as the Endometriosis Health Profile (EHP-30).

Source: https://euclinicaltrials.eu/ctis-public/view/2025-522812-18-00